EU clinical trial 2023-508904-39-00: Rivaroxaban Monotherapy and CYP2C19 Genotype Testing in Patients with Atrial Fibrillation and Percutaneous Coronary Intervention
Sponsor: Amsterdam UMC (Hospital/Clinic/Other health care facility). Phase: Therapeutic use (Phase IV). Countries: Netherlands (ongoing, recruitment ended).
Therapeutic area(s): Diseases [C] - Cardiovascular Diseases [C14]
Gender: Female, Male. Age: 18-64 years, 65+ years. Enrolment: 50.
Status: Ongoing, recruitment ended. Start date (EU): 2024-08-22. Decision date: 2024-03-18. Results received: No. Last updated: 2024-06-21.
Decision dates by country: NL: 2024-05-15

Condition(s): Coronary artery disease, Percutaneous coronary intervention, Atrial fibrillation
Product: Xarelto 15 mg film-coated tablets, Xarelto 20 mg film-coated tablets

Primary endpoint: The primary ischemic endpoints at 6 months is the composite of all-cause mortality, myocardial infarction (according to the 4th universal definition of MI), Academic Research Consortium (ARC) defined definite stent thrombosis, or ischemic stroke, The primary bleeding endpoint at 6 months is major bleeding or clinically relevant non-major bleeding according to the International Society on Thrombosis and Haemostasis (ISTH) criteria

Source: https://euclinicaltrials.eu/ctis-public/view/2023-508904-39-00